EU clinical trial 2025-523804-62-00: Efficacy and safety of NNC0487-0111s.c once weekly in participants with obesity who have reached target dose during run-in period (AMAZE12).
Protocol code: NN9490-8559
Sponsor: Novo Nordisk A/S (Pharmaceutical company). Phase: Therapeutic confirmatory (Phase III). Countries: Belgium (ongoing, recruiting), Germany (ongoing, recruiting), Bulgaria (ongoing, recruiting), France (ongoing, recruiting), Spain (ongoing, recruiting), Denmark (ongoing, recruiting), Italy (ongoing, recruiting), Netherlands (ongoing, recruiting).
Therapeutic area(s): Diseases [C] - Nutritional and Metabolic Diseases [C18]
Gender: Female, Male. Age: 18-64 years. Enrolment: 325.
Status: Ongoing, recruiting. Start date (EU): 2026-04-28. Decision date: 2026-04-27. Results received: No. Last updated: 2026-05-04.
Decision dates by country: BE: 2026-04-27, BG: 2026-05-04, DK: 2026-04-28, FR: 2026-04-27, DE: 2026-04-29, IT: 2026-04-28, ES: 2026-05-04, NL: 2026-04-28

Condition(s): Obesity
Product: NNC0487-0111 B 10142, NNC0487-0111 B 10143, NNC0487-0111 B 10141, NNC0487-0111 B 10145, Placebo, NNC0487-0111 B 10146, NNC0487-0111 B 10144

Primary endpoint: Relative change in body weight
Endpoint(s): Relative change in body weight, CCI, CCI, CCI, Change in waist circumference, Change in systolic blood pressure (SBP), Change in Impact of Weight on Quality of Life-Lite Clinical Trials Version (IWQOL-Lite-CT) Physical function score, Change in SF-36v2® Health Survey Acute (SF-36v2 Acute) Physical functioning score, Change in body weight, Change in body mass index (BMI), CCI, Change in glycated haemoglobin (HbA1c), Change in fasting plasma glucose (FPG), Change in fasting insulin, Change in diastolic blood pressure (DBP), Change in lipids: Total cholesterol High-density lipoprotein (HDL) cholesterol Low-density lipoprotein (LDL) cholesterol Very low-density lipoprotein (VLDL) cholesterol Non-HDL cholesterol Triglycerides, Change in high-sensitivity C-reactive protein (hsCRP), Change in IWQOL-Lite-CT: Physical composite score Psychosocial composite score Total score, CCI, Number of: Treatment Emergent Adverse Events (TEAEs) Treatment Emergent Serious Adverse Events (TESAEs) TEAEs leading to permanent treatment discontinuation

Source: https://euclinicaltrials.eu/ctis-public/view/2025-523804-62-00